EU clinical trial 2023-503312-32-00: TGF-β And PDL-1 inhibition with Bintrafusp alfa in Esophageal Squamous Cell carcinoma combined with chemoradiation TheRapY (TAPESTRY)
Protocol code: 73750
Sponsor: Amsterdam UMC (Hospital/Clinic/Other health care facility). Phase: Therapeutic exploratory (Phase II). Countries: Netherlands (ongoing, recruitment ended).
Therapeutic area(s): Diseases [C] - Neoplasms [C04]; Diseases [C] - Digestive System Diseases [C06]
Gender: Female, Male. Age: 18-64 years, 65+ years. Enrolment: 67.
Status: Ongoing, recruitment ended. Start date (EU): 2024-06-24. Decision date: 2024-06-24. Results received: No. Last updated: 2024-06-24.

Condition(s): Esophageal squamous cell carcinoma
Product: Bintrafusp alfa (anti-PD-L1/TGFβ Trap)

Primary endpoint: The primary endpoint is feasibility defined as percentage of patients that complets at least two of the three planned cylces of bintrafusp alfa
Endpoint(s): Incidence and severity of toxicity defined according to CTCAE v5 and Radiation Oncology Group (RTOG) criteria, Safety of bintrafusp alfa in combination with definitive chemoradiotherapy, Percentage completion of chemotherapy and radiation treatment, Infield locoregional progression free survival, Any progression free survival, Overall survival, Quality of life, with a special focus on dysphagia, Potential biomarker development based on assessment of tumour and duodenal biopsies, faeces and blood samples, Occurrence of TEAEs and treatment related AEs, including abnormalities (grade ≥3) in laboratory tests, Patient reported outcomes other than quality of life, including but not limited to anxiety and depression, worry of cancer progression and work productivity.

Source: https://euclinicaltrials.eu/ctis-public/view/2023-503312-32-00